EU clinical trial 2024-516580-87-00: Dual-immunotherapy and short-course medium-dose radiotherapy, followed by surgery for tumor microenvironment modification in early-stage NSCLC: the DIRECT-trial
Sponsor: Stichting Amsterdam UMC (Hospital/Clinic/Other health care facility). Phase: Phase I and Phase II (Integrated)- Other. Countries: Netherlands (authorised, recruiting).
Therapeutic area(s): Diseases [C] - Neoplasms [C04]; Diseases [C] - Respiratory Tract Diseases [C08]
Gender: Female, Male. Age: 18-64 years, 65+ years. Enrolment: 12.
Status: Authorised, recruiting. Start date (EU): 2024-10-29. Decision date: 2024-10-29. Results received: No. Last updated: 2024-10-29.

Condition(s): early stage NSCLC
Product: IMFINZI 50 mg/mL concentrate for solution for infusion.

Primary endpoint: Safety defined as the percentage of patients with adverse events., Major pathological response (MPR) and pathological complete response (pCR) rates in resected tumor-specimens.
Endpoint(s): Tumor immune infiltration after durvalumab and RT in 4 categories., Radiological response to durvalumab and RT using RECIST v1.1 criteria, and metabolic response based on 18F-FDG PET.

Source: https://euclinicaltrials.eu/ctis-public/view/2024-516580-87-00